EU clinical trial 2024-516731-27-00: FIBRINOGEN REPLACEMENT TO PREVENT INTRACRANIAL HAEMORRHAGE IN ISCHEMIC STROKE PATIENTS AFTER THROMBOLYSIS: A PILOT PROBE RANDOMIZED CONTROLLED TRIAL
Sponsor: Azienda Unita Sanitaria Locale Di Bologna (Hospital/Clinic/Other health care facility). Phase: Therapeutic confirmatory (Phase III). Countries: Italy (authorised, recruitment pending).
Therapeutic area(s): Diseases [C] - Cardiovascular Diseases [C14]
Gender: Female, Male. Age: 18-64 years, 65+ years. Enrolment: 200.
Status: Authorised, recruitment pending. Decision date: 2024-09-04. Results received: No. Last updated: 2024-09-04.

Condition(s): Ischemic stroke patients with secondary post-rtPA hypofibrinogenemia
Product: Riastap 1 g, Polvere per soluzione iniettabile o per infusione

Primary endpoint: To evaluate the efficacy of fibrinogen infusion in stroke patients with secondary post-rtPA hypofibrinogenemia in reducing the rate of ICH defined as parenchymal hematoma (PH1, PH2 and remote ones), To evaluate the efficacy of fibrinogen infusion in stroke patients with secondary post-rtPA hypofibrinogenemia in: - sICH according NINDS, ECASS and SITS classifications. - extracerebral bleedings
Endpoint(s): To evaluate the safety of fibrinogen infusion in stroke patients with secondary postrtPA hypofibrinogenemia: - Serious thromboembolic adverse events at 7 days after randomization (deep vein thrombosis, pulmonary embolism, myocardial infarct, recurrence of ischemic stroke, MACE defined as all-cause mortality, nonfatal myocardial infarction, andnonfatal stroke), To evaluate the efficacy of fibrinogen infusion in stroke patients with secondary post-rtPA hypofibrinogenemia in the clinical outcome defined as: - National Institutes of Health Stroke Scale score (NIHSS) at day 7 - disability at 3 months, assessed with the modified Rankin Scale (mRS). Good outcome is considered as mRS 0-2, To evaluate the diagnosis of hyperfibrinolysis detected with Rotation thromboelastometry (ROTEM) in the whole ischemic stroke population randomized in the RCT (200 patients), To correlate hyperfibrinolysis with cerebral bleeding in the whole ischemic stroke population and in each arm

Source: https://euclinicaltrials.eu/ctis-public/view/2024-516731-27-00